EU clinical trial 2023-506662-31-00: Adjuvant TRastuzumab deruxtecan plus fluoropyrimidine versus standard chemotherapy In HER2-positive gastric or gastroesophageal cancer patients with persistence of miNImal residual disease in liquid biopsy after pre-operative chemoTherapy and radical surgerY: the TRINITY study
Sponsor: Fondazione GONO G.I. (Patient organisation/association). Phase: Therapeutic exploratory (Phase II). Countries: Italy (ongoing, recruiting).
Therapeutic area(s): Diseases [C] - Neoplasms [C04]
Gender: Female, Male. Age: 18-64 years, 65+ years. Enrolment: 46.
Status: Ongoing, recruiting. Start date (EU): 2024-02-28. Decision date: 2024-01-18. Results received: No. Last updated: 2026-06-03.

Condition(s): Gastric or gastroesophageal cancer
Product: CALCIUM LEVOFOLINATE, FLUOROURACIL, OXALIPLATIN, DOCETAXEL, DS-8201a, CAPECITABINE, FLUOROURACIL

Primary endpoint: The rate of patients with ctDNA clearance after adjuvant T-DXd plus capecitabine/5-fluorouracil versus post-operative FLOT continuation treatment at 1 year from randomization in the intention-to-treat population. Patients with disease relapse or death before the 12-month post-randomization timepoint will be considered in the intention-to-treat population as not having achieved ctDNA clearance.
Endpoint(s): Disease-free survival, defined as time from the randomization in the study to the occurrence of disease relapse (local and/or distant), second GC/GEJC primary, or death from any cause, Overall survival, defined as time from the randomization in the study to the occurrence of death, Metastases-free survival, defined as time from the randomization in the study to the first evidence of metastases according to the radiological and clinical assessments detailed in the procedures or death from any cause

Source: https://euclinicaltrials.eu/ctis-public/view/2023-506662-31-00